EU clinical trial 2024-517120-19-02: Glucagone Like Peptide-1 Receptor (GLP-1R) Analogue Assisted Rapid Weight Loss Program as treatment of Idiopathic Intracranial Hypertension
Sponsor: Rigshospitalet (Hospital/Clinic/Other health care facility). Phase: Therapeutic use (Phase IV). Countries: Denmark (ended).
Therapeutic area(s): Diseases [C] - Hormonal diseases [C19]; Diseases [C] - Eye Diseases [C11]; Diseases [C] - Nutritional and Metabolic Diseases [C18]; Diseases [C] - Nervous System Diseases [C10]
Gender: Female. Age: 18-64 years. Enrolment: 50.
Status: Ended. Start date (EU): 2022-09-02. End date (EU): 2025-10-28. Decision date: 2024-12-09. Results received: No. Last updated: 2025-06-04.

Condition(s): Idiopathic Intracranial Hypertension
Product: Wegovy 2.4 mg solution for injection in pre-filled pen, Ozempic 0.5 mg solution for injection in pre-filled pen, Wegovy 1.7 mg solution for injection in pre-filled pen, Ozempic 0.25 mg solution for injection in pre-filled pen, Ozempic 1 mg solution for injection in pre-filled pen

Primary endpoint: Change in lumbar opening pressure after 8 weeks, Change in body weight after 8 weeks
Endpoint(s): Change in lumbar opening pressure after 10 months, Change in body weight after 10 months, Degree of papilledema (Frisén grade), Visual field perimetric mean deviation (MD) by automated perimetry, Optical coherence tomography (OCT) changes including enhanced depth imaging (EDI) OCT, confocal scanning laser ophthalmoscopy (cSLO) and OCT angiography (OCTA), Optic disc elevation (ODE) and optic nerve sheath diameter (ONSD) by transorbital ultrasonography, HURT score (Headache Under Response to Treatment), Number of monthly headache days, Mean monthly headache intensity, Need of prophylactic and acute headache medication, Percentage in full or partial remission after 10 months (absence of papilledema with or without ICP < 25 cm CSF, respectively), Body fat percentage and truncal adiposity (8 weeks and 10 months DEXA scan), Quality of life (WHO QoL questionnaire short version, 8 weeks and 10 months), Drop-out before 8 weeks and 10-month follow-up, Urinary ketosis, Use of ICP regulating medication including Acetazolamide, Topiramate, diuretics (daily dose and length of treatment), Biomarkers in CSF, blood, and urine (baseline, 8 weeks and 10 months), including change in metabolic parameters (HOMA2IR, HbA1c, glucose, serum lipids, biomarkers of the adrenal system, and liver and kidney function, etc.), Adverse events and reactions, Presence of non-alcoholic fatty liver disease (NAFLD) (8 weeks and 10 months) assessed by ultrasonography, Concentratoin Semaglutide in cerebrospinal fluid

Source: https://euclinicaltrials.eu/ctis-public/view/2024-517120-19-02